EU clinical trial 2024-520326-11-00: Prospective Phase II study on Safety and Efficacy of Fludarabine plus Treosulfan (14g) (FT14) conditioning regimen for allogeneic Stem Cell Transplantation (allo-SCT) in Acute Myeloid Leukemia (AML) patients (≥40 <65years)
Sponsor: Azienda Socio Sanitaria Territoriale Degli Spedali Civili Di Brescia (Hospital/Clinic/Other health care facility). Phase: Therapeutic exploratory (Phase II). Countries: Italy (authorised, recruitment pending).
Therapeutic area(s): Diseases [C] - Hemic and Lymphatic Diseases [C15]
Gender: Female, Male. Age: 18-64 years. Enrolment: 82.
Status: Authorised, recruitment pending. Decision date: 2025-01-31. Results received: No. Last updated: 2025-01-31.

Condition(s): Acute Myeloid Leukemia (AML)
Product: Treosulfan Tillomed 5g polvere per soluzione per infusione, FLUDARABINE TEVA 25 mg/ml, solution à diluer pour injectable ou perfusion, CICLOSPORIN, ANTITHYMOCYTE IMMUNOGLOBULIN (RABBIT), METHOTREXATE, Grafalon 20 mg/ml concentrato per soluzione per infusione

Primary endpoint: The 1-year leukemia -free survival (LFS) after allo-SCT

Source: https://euclinicaltrials.eu/ctis-public/view/2024-520326-11-00